EU clinical trial 2023-508118-40-01: A Phase 2 Proof-of-Concept clinical trial to quantify myocardial manganese uptake rate by cardiovascular magnetic resonance imaging following mangafodipir trisodium administration in healthy volunteers and heart failure patients with preserved ejection fraction caused by hypertrophic cardiomyopathy or cardiac amyloidosis.
Protocol code: MNC001
Sponsor: IC Targets AS (Pharmaceutical company). Phase: Therapeutic exploratory (Phase II). Countries: Norway (ended).
Therapeutic area(s): Diseases [C] - Cardiovascular Diseases [C14]
Gender: Female, Male. Age: 18-64 years, 65+ years. Enrolment: 42.
Status: Ended. Start date (EU): 2024-11-22. End date (EU): 2025-11-29. Decision date: 2024-09-20. Results received: No. Last updated: 2025-12-16.

Condition(s): Heart Failure
Product: Dotarem 279,3 mg/ml injeksjonsvæske, oppløsning, ANHYDROUS MANGAFODIPIR TRISODIUM

Primary endpoint: Determination of the manganese uptake rate.
Endpoint(s): Efficacy: Difference in the uptake rate constant between healthy volunteers, HFpEF with HCM or CA., Safety: Frequency and severity of adverse events, injection site AEs, significant changes in vital signs, significant changes in ECG

Source: https://euclinicaltrials.eu/ctis-public/view/2023-508118-40-01